EU clinical trial 2024-519783-41-00: Early optimization of ceftazidine dosing regimen in critical care : FORTOPTIM_1
Protocol code: 24PH176_1
Sponsor: Centre Hospitalier Universitaire De Saint Etienne (Hospital/Clinic/Other health care facility). Phase: Therapeutic exploratory (Phase II). Countries: France (authorised, recruitment pending).
Therapeutic area(s): Analytical, Diagnostic and Therapeutic Techniques and Equipment [E] - Therapeutics [E02]; Diseases [C] - Bacterial Infections and Mycoses [C01]
Gender: Female, Male. Age: 18-64 years, 65+ years. Enrolment: 128.
Status: Authorised, recruitment pending. Decision date: 2025-07-24. Results received: No. Last updated: 2026-02-12.

Condition(s): sepsis
Product: CEFTAZIDIME, CEFTAZIDIME

Primary endpoint: Percentage of subjects with a ceftazidime concentration equal to or above the target concentration threshold (35 mg/L) at both 3h and 24h after the first administration and below the toxicity threshold of 100 mg/L
Endpoint(s): Patient severity assessed using the SOFA (Sepsis related Organ Failure Assessment) score at D0 and D7. The SOFA score is a tool used in intensive care to assess the severity of organ failure in critical patients. The score assesses the function of six systems: respiratory, cardiovascular, hepatic, hemostatic, renal and neurological. Each system is scored from 0 to 4, meaning that the total SOFA score can vary from 0 to 24. There is no specific threshold for determining disease severity, as the S, Death up to D28, Occurrence of neurological adverse events defined as: seizure, myoclonus, encephalopathy or delirium, altered consciousness (Glasgow score), Occurrence of an overdose defined as a concentration greater than 100 mg/L, Renal function assessed using the following estimators: creatinemia cystatin CKD-EPI, creatinuria/creatininemia ratio (U×V/P) and eGFR creat-cystatin, Time to reach PK/PD targets (in hours post treatment introduction)

Source: https://euclinicaltrials.eu/ctis-public/view/2024-519783-41-00